EU clinical trial 2023-506948-17-00: A Phase 3, Open-Label, Randomized Study of Sonrotoclax (BGB-11417) Plus Zanubrutinib (BGB-3111) Compared With Venetoclax Plus Obinutuzumab in Patients With Previously Untreated Chronic Lymphocytic Leukemia
Sponsor: BeOne Medicines AG (Pharmaceutical company). Phase: Therapeutic confirmatory (Phase III). Countries: Netherlands (ongoing, recruitment ended), Czechia (ongoing, recruitment ended), Austria (ongoing, recruitment ended), Italy (ongoing, recruitment ended), France (ongoing, recruitment ended), Spain (ongoing, recruitment ended), Poland (ongoing, recruitment ended), Germany (ongoing, recruitment ended), Sweden (ongoing, recruitment ended).
Therapeutic area(s): Diseases [C] - Neoplasms [C04]
Gender: Female, Male. Age: 18-64 years, 65+ years. Enrolment: 206.
Status: Ongoing, recruitment ended. Start date (EU): 2024-04-05. Decision date: 2024-03-04. Results received: No. Last updated: 2026-04-14.
Decision dates by country: ES: 2024-03-04, SE: 2024-06-05, PL: 2024-03-08, CZ: 2024-03-07, NL: 2024-03-07, IT: 2024-04-22, DE: 2024-05-29, FR: 2024-03-06, AT: 2024-03-12

Condition(s): Previously Untreated Chronic Lymphocytic Leukemia
Product: BGB-11417, Zanubrutinib, BGB-11417, Venclyxto 100 mg film-coated tablets, Gazyvaro 1,000 mg concentrate for solution for infusion., BGB-11417, BGB-11417

Primary endpoint: Cohort 1: PFS, defined as time from the date of enrollment to the date of first confirmed disease progression or death due to any cause, whichever occurs first, as determined by IRC., Intermediate (Cohort 1): Undetectable minimal residual disease at < 10^-4 sensitivity (uMRD4) rate at the first Post-treatment Follow-up (PTFU1) Visit based on next-generation sequencing (NGS [clonoSEQ]).
Endpoint(s): Cohort 1: Overall complete response rate (CRR) defined as the proportion of patients that achieved best response of CR/CRi, determined by IRC., Cohort 1: OS, defined as time from the date of enrollment to the date of death because of any cause

Source: https://euclinicaltrials.eu/ctis-public/view/2023-506948-17-00